EU clinical trial 2025-522835-32-00: A Phase 2, Multicenter, Randomized, Double-blind Study of Safety and Efficacy of EL219 versus Standard of Care (Liposomal Amphotericin B followed by Voriconazole) for Early Antifungal Therapy of Suspected Invasive Mould Infections
Protocol code: EL219.IV.2.04
Sponsor: Elion Therapeutics Inc. (Pharmaceutical company). Phase: Therapeutic exploratory (Phase II). Countries: Belgium (ongoing, recruiting), France (authorised, recruiting), Spain (ongoing, recruiting), Italy (ongoing, recruiting).
Therapeutic area(s): Diseases [C] - Bacterial Infections and Mycoses [C01]
Gender: Female, Male. Age: 18-64 years, 65+ years. Enrolment: 54.
Start date (EU): 2026-05-08. Decision date: 2026-02-26. Results received: No. Last updated: 2026-04-22.
Decision dates by country: ES: 2026-02-27, IT: 2026-02-27, BE: 2026-02-26, FR: 2026-02-26

Condition(s): Suspected Invasive Mould Infection
Product: OE Voriconazole, VORICONAZOLE, AMPHOTERICINE B, LIPOSOME, Oral voriconazole matching placebo, Dextrose 5% (EL219, LAmB, IV voriconazole matching placebo for blinding purpose), EL219

Primary endpoint: 1_All-cause mortality at Day 42 in the Intent-to-Treat (ITT) analysis set, 2_Serious adverse events (SAEs) and treatment emergent adverse events (TEAEs) categorized in a tiered approach in the Safety analysis set. Tier1 TEAEs include renal, electrolyte, hepatic, infusion-related reactions, photophobia, and photosensitivity. Tier 2 includes all other TEAEs
Endpoint(s): 1_Overall success at Day 42, confirmed by the Data Review Committee (DRC), in the population with proven or probable IA (modified Intent-to-Treat [mITT]) as measured by: - Participant is alive, - favorable composite clinical, mycologic, and radiographic response (European Organization for Research and Treatment of Cancer/Invasive Fungal Infections Cooperative Group and the National Institute of Allergy and Infectious Diseases Mycoses Study Group [EORTC/MSG] criteria), 2_Early antifungal therapy (EAT) success at Day 42 in the ITT analysis set defined by non-occurrence of the following: death, receipt of non-study drug systemic antifungal therapy for a cumulative exposure >10 days for progression of disease and/or toxicity, missing data (classified as indeterminate but analyzed as a failure), 3_Breakthrough possible, probable, or proven IFI established after 14 days of study drug in the ITT analysis set, 4_Duration of the initial hospitalization after randomization, in the ITT analysis set, 5_Motif et durée de réhospitalisation après la sortie d’hôpital à l’issue de l’hospitalisation initiale, dans l’ensemble d’analyse ITT

Source: https://euclinicaltrials.eu/ctis-public/view/2025-522835-32-00